EU clinical trial 2023-508902-66-00: ICON study: A phase 2 study of CC220 (iberdomide) combined with low-dose cyclophosphamide and dexamethasone in relapsed/refractory multiple myeloma (IberCd)
Protocol code: HAEM-2020-1
Sponsor: Amsterdam UMC (Hospital/Clinic/Other health care facility). Phase: Therapeutic exploratory (Phase II). Countries: Netherlands (ongoing, recruitment ended).
Therapeutic area(s): Diseases [C] - Neoplasms [C04]
Gender: Female, Male. Age: 18-64 years, 65+ years. Enrolment: 60.
Status: Ongoing, recruitment ended. Start date (EU): 2024-11-28. Decision date: 2024-11-28. Results received: No. Last updated: 2026-05-22.

Condition(s): relapsed / refractory multiple myeloma
Product: Dexamethason Teva 4 mg, tabletten, Iberdomide, ENDOXAN omhulde tablet, omhulde tabletten, 50 mg., Iberdomide, Iberdomide, Iberdomide

Primary endpoint: Progression free survival (PFS; i.e. time from the first dose of iberdomide-cyclophosphamide-dexamethasone to progression or death from any cause, whichever comes first)
Endpoint(s): Overall response rate. In this analysis we will consider the best response obtained during treatment according to the international myeloma working group (IMWG) criteria, Safety and toxicity as defined by type, frequency and severity of adverse events as defined by the National Cancer Institute (NCI) Common Terminology Criteria for Adverse Events (CTCAE), version 4.03, Overall survival measured from first dose of iberdomide-cyclophosphamide-dexamethasone, to time of death from any cause. Patients still alive or lost to follow up are censored at the date they were last known to be alive., Time to response defined as time from first dose of iberdomide-cyclophosphamidedexamethasone to the first objective documentation of PR or better., Duration of response defined as time from documentation of tumor response to disease progression., Time to second objective disease progression (PFS2) defined as time from first dose of iberdomide-cyclophosphamide-dexamethasone to 2nd disease progression or death from any cause., Time to next treatment (TTNT) defined as the date from first dose of iberdomide- cyclophosphamide-dexamethasone to first day when subject receives another myeloma treatment. Subjects who do not start new myeloma therapy are censored at the last known alive date or first dose date, whichever is later.

Source: https://euclinicaltrials.eu/ctis-public/view/2023-508902-66-00